EU clinical trial 2023-505907-21-00: A Mechanistic Study to Evaluate Impact of Afamelanotide in Aqueous Solution on Ultraviolet Radiation-Induced DNA Damage and DNA Repair Capacity in Healthy Volunteers
Protocol code: CUV158
Sponsor: Clinuvel Europe Limited (Pharmaceutical company). Phase: Therapeutic exploratory (Phase II). Countries: Germany (authorised, recruitment pending).
Therapeutic area(s): Not possible to specify
Gender: Female, Male. Age: 18-64 years. Enrolment: 10.
Status: Authorised, recruitment pending. Decision date: 2024-02-06. Results received: No. Last updated: 2025-12-22.

Condition(s): Healthy volunteers
Product: PRENUMBRA

Primary endpoint: The changes in UV photoproducts from pre to post afamelanotide in UVR exposed skin and in non-irradiated skin.

Source: https://euclinicaltrials.eu/ctis-public/view/2023-505907-21-00